EU clinical trial 2025-520902-37-00: A Phase 2, Randomized, Double-Blind, Placebo-Controlled Study of V940 in Combination With Pembrolizumab and Chemotherapy as First-Line Treatment for Participants With Metastatic Squamous NSCLC (INTerpath-013)
Protocol code: V940-013
Sponsor: Merck Sharp & Dohme LLC (Pharmaceutical company). Phase: Therapeutic exploratory (Phase II). Countries: Italy (ongoing, recruiting), Spain (ongoing, recruiting), Poland (ongoing, recruiting), France (ongoing, recruiting).
Therapeutic area(s): Diseases [C] - Neoplasms [C04]
Gender: Female, Male. Age: 18-64 years, 65+ years. Enrolment: 59.
Status: Ongoing, recruiting. Start date (EU): 2026-04-01. Decision date: 2026-03-23. Results received: No. Last updated: 2026-08-05.
Decision dates by country: IT: 2026-03-23, FR: 2026-03-30, PL: 2026-03-27, ES: 2026-03-27

Condition(s): Non-small cell lung cancer stage IV
Product: mRNA-4157, DOCETAXEL, PACLITAXEL ALBUMIN-BOUND, KEYTRUDA 25 mg/mL concentrate for solution for infusion., CARBOPLATIN, PACLITAXEL, Placebo to V940

Primary endpoint: Progression-free survival (PFS), Overall survival (OS)
Endpoint(s): Objective response rate (ORR), Duration of response (DOR), Number of Participants With ≥1 Adverse Event (AE), Number of Participants Discontinuing From Study Therapy Due to an AE

Source: https://euclinicaltrials.eu/ctis-public/view/2025-520902-37-00